EU clinical trial 2024-518829-15-00: A Phase 1/2 Open-label Study to Investigate the Safety of Sonrotoclax Ramp-up Schedule(s) in Adult Patients With Hematological Malignancies
Protocol code: BGB-11417-108
Sponsor: BeOne Medicines AG (Pharmaceutical company). Phase: Phase I and Phase II (Integrated)- Other. Countries: France (ongoing, recruiting).
Therapeutic area(s): Diseases [C] - Neoplasms [C04]
Gender: Female, Male. Age: 18-64 years, 65+ years. Enrolment: 14.
Status: Ongoing, recruiting. Start date (EU): 2025-07-02. Decision date: 2025-04-22. Results received: No. Last updated: 2026-03-25.

Condition(s): previously untreated chronic lymphocytic leukemia (CLL)
Product: BGB-11417, Zanubrutinib, BGB-11417, BGB-11417, BGB-11417

Primary endpoint: Incidence and severity of TLS (both laboratory and clinical TLS) as defined by Howard criteria during the SLT evaluation window
Endpoint(s): Safety via incidence and severity of treatment-emergent adverse events, serious adverse events, and adverse events according to NCI-CTCAE v5.0; Tolerability as determined by protocol-defined SLTs during the SLT evaluation window, Incidence of dose modifications (dose modified, held, or discontinued), during the SLT evaluation window

Source: https://euclinicaltrials.eu/ctis-public/view/2024-518829-15-00